EU clinical trial 2023-506641-35-00: A Phase 2 Multicenter Study Evaluating the Efficacy of KTE-X19 in Subjects with Relapsed/Refractory Mantle Cell Lymphoma (ZUMA-2)
Protocol code: KTE-C19-102
Sponsor: Kite Pharma Inc. (Pharmaceutical company). Phase: Therapeutic exploratory (Phase II). Countries: France (ended), Spain (ended), Germany (ended), Netherlands (ended).
Therapeutic area(s): Diseases [C] - Neoplasms [C04]
Gender: Female, Male. Age: 18-64 years, 65+ years. Enrolment: 68.
Status: Ended. Start date (EU): 2018-07-09. End date (EU): 2025-05-21. End date: 2025-06-18. Decision date: 2023-12-19. Results received: Yes. Last updated: 2025-03-10.
Decision dates by country: FR: 2023-12-19, DE: 2024-01-12, NL: 2023-12-20, ES: 2023-12-19

Condition(s): Relapsed/Refractory Mantle Cell Lymphoma
Product: Dexamethasone 4 mg tablets, Cytarabine 20 mg/ml Solution for Injection or Infusion, Calquence 100 mg hard capsules, Cyclophosphamide 500 mg Powder for Solution for Injection or Infusion, Fludarabine phosphate 25 mg/ml Concentrate for Solution for Injection or Infusion, Histergan Tablets, Tecartus 0.4 - 2 x 10e8 cells dispersion for infusion, Mesna Injection, Methylprednisolone 1000 mg powder and solvent for solution for injection/infusion, RoActemra 20 mg/mL concentrate for solution for infusion, Panadol 500 mg Film Coated Tablets, IMBRUVICA 140 mg hard capsules

Primary endpoint: ORR (complete response [CR] + partial response [PR]) per the Lugano Classification per Independent Radiology Review Committee (IRRC) review
Endpoint(s): DOR, Best objective response (BOR), ORR as determined by study investigators, Progression-free survival, Overall survival, Incidence of adverse events (AEs) and clinically significant changes in laboratory values, Incidence of anti-CD19 CAR antibodies, Levels of anti-CD19 CAR T cells in blood, Levels of cytokines in serum, Changes over time in the EQ-5D scale score and visual analogue scale score, Changes over time in the EORTC-QLQ-C30 score (Cohort 3 only)

Source: https://euclinicaltrials.eu/ctis-public/view/2023-506641-35-00